EU clinical trial 2025-523756-31-00: A Study of PHN-012 in Patients With Advanced Solid Tumors
Protocol code: PHN-012-001
Sponsor: Pheon Therapeutics Limited (Pharmaceutical company). Phase: Human Pharmacology (Phase I)- First administration to humans. Countries: Spain (ongoing, recruiting).
Therapeutic area(s): Diseases [C] - Neoplasms [C04]
Gender: Female, Male. Age: 18-64 years, 65+ years. Enrolment: 50.
Status: Ongoing, recruiting. Start date (EU): 2026-03-26. Decision date: 2026-03-06. Results received: No. Last updated: 2026-03-06.

Condition(s): Advanced Solid Tumors

Source: https://euclinicaltrials.eu/ctis-public/view/2025-523756-31-00